EU clinical trial 2024-515938-32-00: Lymph Node Microenvironment Modifications in Patients with CLL Treated with Venetoclax-based regimens
Sponsor: Ospedale San Raffaele S.r.l. (Hospital/Clinic/Other health care facility). Phase: Therapeutic use (Phase IV). Countries: Italy (temporarily halted).
Therapeutic area(s): Diseases [C] - Neoplasms [C04]
Gender: Female, Male. Age: 18-64 years, 65+ years. Enrolment: 30.
Status: Temporarily halted. Start date (EU): 2022-08-04. Decision date: 2024-11-19. Results received: No. Last updated: 2024-11-19.

Condition(s): Chronic Lymphocytic Leukemia
Product: VENETOCLAX

Primary endpoint: Characterization by immunohistochemistry, gene expression profile, protein expression and proliferative activity of CLL lymphocytes and LN-derived accessory cells of CLL patients treated with venetoclax-based regimens 12 months after completion of the venetoclax ramp-up phase, Definition of ultrasound characteristics of LNs in CLL patients treated with venetoclax-based regimens 12 months after completion of the venetoclax acceleration phase

Source: https://euclinicaltrials.eu/ctis-public/view/2024-515938-32-00